EU clinical trial 2023-509009-59-00: Psilocybin's effects on anhedonia
Sponsor: Medical University of Vienna (Educational Institution). Phase: Human Pharmacology (Phase I)- Other. Countries: Austria (not authorised).
Therapeutic area(s): Psychiatry and Psychology [F] - Psychological Phenomena [F02]; Psychiatry and Psychology [F] - Behavior and Behavior Mechanisms [F01]; Psychiatry and Psychology [F] - Mental Disorders [F03]
Gender: Female, Male. Age: 18-64 years. Enrolment: 85.
Status: Not authorised. Decision date: 2024-08-05. Results received: No. Last updated: 2024-08-05.

Condition(s): Major Depressive Disorder

Source: https://euclinicaltrials.eu/ctis-public/view/2023-509009-59-00